EU clinical trial 2023-510324-77-00: A Clinical Trial to Assess the Safety of SOR102 in Healthy Participants and Patients with Ulcerative Colitis
Protocol code: SOR102-101
Sponsor: Sorriso Pharmaceuticals Inc. (Pharmaceutical company). Phase: Human Pharmacology (Phase I)- First administration to humans. Countries: Bulgaria (ended), Poland (ended).
Therapeutic area(s): Diseases [C] - Digestive System Diseases [C06]
Gender: Female, Male. Age: 18-64 years. Enrolment: 9.
Status: Ended. Start date (EU): 2024-10-20. End date (EU): 2024-10-21. End date: 2024-10-22. Decision date: 2024-06-14. Results received: No. Last updated: 2024-09-09.
Decision dates by country: BG: 2024-06-17, PL: 2024-06-14

Condition(s): Ulcerative colitis

Source: https://euclinicaltrials.eu/ctis-public/view/2023-510324-77-00